EU clinical trial 2024-513431-25-00: Phase I / II Clinical Trial, multicenter, open, of infusion of activated NK cells for the treatment of children, adolescents and young adults with sarcomas.
Sponsor: Hospital Universitario La Paz (Hospital/Clinic/Other health care facility). Phase: Phase I and Phase II (Integrated)- First administration to humans. Countries: Spain (ongoing, recruiting).
Therapeutic area(s): Diseases [C] - Neoplasms [C04]
Gender: Female, Male. Age: 0-17 years, 18-64 years. Enrolment: 10.
Status: Ongoing, recruiting. Start date (EU): 2022-10-18. Decision date: 2024-04-18. Results received: No. Last updated: 2024-04-18.

Condition(s): Sarcomas
Product: Allogeneic peripheral blood-derived CD56+ natural killer cells, co-cultured with K562-mb15-41BBI cell line

Primary endpoint: Toxicity will be classified according to the common toxicity criteria established by the National Cancer Institute (CTC NCI, version 5.0).
Endpoint(s): Incidence of episodes of febrile neutropenia, bacteraemia, infections (viral, fungal), haematological recovery and hospital admission associated with treatment., Five-year disease progression rate after treatment with NK cells + IL-2. This will be determined by imaging techniques., Expression levels of NK cell inhibitory/activating ligands in solid tumour samples and patient serum. These shall be determined by immunohistochemistry and PCR techniques.

Source: https://euclinicaltrials.eu/ctis-public/view/2024-513431-25-00